EU clinical trial 2023-503910-60-00: A Phase 2 Randomized, Double-blind, Placebo-controlled, Dose-ranging, Efficacy and Safety study of SAR441566 plus Methotrexate in Adults with Moderate to Severe Rheumatoid Arthritis
Protocol code: DRI17821
Sponsor: Sanofi-Aventis Recherche & Developpement (Pharmaceutical company). Phase: Therapeutic exploratory (Phase II). Countries: Slovakia (ended), Czechia (ended), Germany (ended), Poland (ended), Greece (ended), Spain (ended).
Therapeutic area(s): Diseases [C] - Immune System Diseases [C20]
Gender: Female, Male. Age: 18-64 years, 65+ years. Enrolment: 194.
Status: Ended. Start date (EU): 2024-03-05. End date (EU): 2025-07-02. End date: 2025-07-03. Decision date: 2024-02-01. Results received: Yes. Last updated: 2025-08-19.
Decision dates by country: GR: 2024-06-03, SK: 2024-02-01, CZ: 2024-02-06, ES: 2024-03-12, PL: 2024-02-02, DE: 2024-02-05

Condition(s): Rheumatoid arthritis
Product: Match placebo to test product, METHOTREXATE, SAR441566, SAR441566

Primary endpoint: Proportion of participants achieving at least 20% improvement from baseline in the American College of Rheumatology (ACR) score at week 12
Endpoint(s): Change from baseline in Disease activity score – C-reactive protein (DAS-28 CRP) at week 12, Proportion of participants achieving at least 50% improvement from baseline in the ACR score at week 12, Number of participants with Treatment-Emergent Adverse Events (TEAEs), serious AEs (SAEs), and AEs of special interest (AESIs), Plasma pre-dose concentrations of SAR441566, Plasma post-dose concentrations of SAR441566

Source: https://euclinicaltrials.eu/ctis-public/view/2023-503910-60-00